EU clinical trial 2023-506000-50-00: A Phase 2a Randomised, Double-Blind, Placebo-Controlled, Study to Evaluate the Efficacy and Safety of AZD4604 Twice Daily for Twelve Weeks in Adult Patients with Moderate to Severe Asthma Uncontrolled on Medium-High Dose ICS-LABA
Protocol code: D8210C00003
Sponsor: Astrazeneca AB (Pharmaceutical company). Phase: Therapeutic exploratory (Phase II). Countries: Sweden (ended), Bulgaria (ended), France (ended), Germany (ended), Denmark (ended), Spain (ended), Netherlands (ended).
Therapeutic area(s): Diseases [C] - Respiratory Tract Diseases [C08]
Gender: Female, Male. Age: 18-64 years. Enrolment: 124.
Status: Ended. Start date (EU): 2024-09-26. End date (EU): 2025-06-12. End date: 2025-10-28. Decision date: 2024-02-07. Results received: No. Last updated: 2025-06-04.
Decision dates by country: NL: 2024-02-12, SE: 2024-02-09, FR: 2024-02-12, BG: 2024-02-12, ES: 2024-02-09, DE: 2024-02-08, DK: 2024-02-07

Condition(s): Adult Patients with Moderate-to-Severe Asthma Uncontrolled on Medium-High Dose ICS-LABA
Product: AZD4604, AZD4604 Placebo, AZD4604

Primary endpoint: Time to first CompEx (composite endpoint for exacerbation) event
Endpoint(s): Change from baseline in: 1 Pre-BD FEV1 at Week 4 and Week 12, CAAT at Week 4 and Week 12, ACQ-6 at Week 4 and Week 12, Average morning and average evening PEF at Week 4 and Week 12, and average over the 12-week Treatment period, Daily asthma symptom score (total, daytime, and night-time) at Week 4 and Week 12

Source: https://euclinicaltrials.eu/ctis-public/view/2023-506000-50-00